EU clinical trial 2023-504999-25-00: CHIP-AML22 Master protocol: An open label complex clinical trial in newly diagnosed pediatric de novo AML patients – a study by the NOPHO-DB-SHIP consortium Master Protocol
Protocol code: MH21CHI
Sponsor: Prinses Maxima Centrum voor Kinderoncologie B.V. (Hospital/Clinic/Other health care facility). Phase: Therapeutic confirmatory (Phase III). Countries: Netherlands (ongoing, recruiting), Belgium (ongoing, recruiting), Denmark (ongoing, recruiting), Estonia (ongoing, recruiting), Iceland (ongoing, recruiting), Latvia (ongoing, recruiting), Lithuania (ongoing, recruiting), Portugal (ongoing, recruiting), Spain (ongoing, recruiting), Sweden (ongoing, recruiting), Norway (ongoing, recruiting), Finland (ongoing, recruiting).
Therapeutic area(s): Diseases [C] - Neoplasms [C04]
Gender: Female, Male. Age: 0-17 years, 18-64 years. Enrolment: 675.
Status: Ongoing, recruiting. Start date (EU): 2023-07-14. Decision date: 2023-10-27. Results received: No. Last updated: 2026-05-26.
Decision dates by country: EE: 2024-08-02, NL: 2023-10-27, PT: 2024-08-28, BE: 2024-07-15, LV: 2024-07-10, LT: 2024-07-09, IS: 2024-05-31, FI: 2024-06-19, ES: 2024-07-03, DK: 2024-08-15, SE: 2024-07-19, NO: 2024-07-16

Condition(s): Acute Myeloid Leukemia
Product: Mitoxantrone 2 mg/ml concentrate for solution for infusion, Cytarabine 100 mg/ml Solution for Injection or Infusion, Di-Adreson-F Aquosum 25 mg, poeder voor oplossing voor injectie., Fludarabine 50mg Powder For Solution For Injection Or Infusion, CARDIOXANE 500 mg powder for solution for infusion, ETOPOPHOS® 100 mg, Pulver zur Herstellung einer Infusionslösung, Solu-Medrone powder and solvent for solution for injection or concentrate for solution for infusion 1000 mg/vial., Daunorubicin 20mg Powder for I.V. Injection, Solu-Cortef Powder for Solution for Injection or Infusion 100 mg, Etoposide 20 mg/ml Concentrate for Solution for Infusion, MYLOTARG 5 mg powder for concentrate for solution for infusion, Methotrexate 2.5 mg/ml Injection

Primary endpoint: Primary endpoint of overarching objective: Event-free survival (EFS), Primary end point induction Randomization: • MRD <0.1% leukemic cells in the BM, as defined by flow cytometry, shortly before start of induction course 2 (BM1)., Primary endpoint of consolidation Randomization: Disease-Free Survival (DFS)
Endpoint(s): Secondary end point secondary objective: • Bone marrow blast counts by morphology and multi-color flow cytometry (MFCM) after course #1 and #2 and before allo-SCT; ORR (CR, CRp, and CRi) and morphologic leukemia-free state (MLFS) rates after course #1 and #2; MRD negativity after course #1 and #2 and before allo-SCT; absolute MRD levels after course #1 and #2 and before allo-SCT. • OS • DFS • CIR., Secondary end point secondary objective: • Cumulative toxicity, defined as the total of grade ≥3 AEs from the start of AML treatment to the end of the reporting period, which are graded by NCI CTCAE version 5.0. • NRM., Secondary end point induction randomization: • Bone marrow blast counts by morphology and multi-color flow cytometry (MFCM) after course #1 and #2 and before allo-SCT; ORR (CR, CRp, and CRi) and morphologic leukemia-free state (MLFS) rates after course #1 and #2; MRD negativity after course #2 and before allo-SCT; absolute MRD levels after course #1 and #2 and before allo-SCT. OS • DFS • EFS • CIR • OS, Secondary end point induction randomization: • Cumulative toxicity, defined as the total of AESIs over time, which are graded by NCI CTCAE version 5.0. • Adverse events (AEs), as characterized by type, frequency, severity (as graded using CTCAE, v5.0). • Serious adverse events (SAEs), as characterized by type, frequency, severity (as graded using CTCAE, v5.0). • NRM., Secondary end point consolidation randomization: • Cumulative toxicity, defined as the as the total of grade ≥3 AEs over time, which are graded by NCI CTCAE version 5.0. • Non-relapse mortality (NRM)., Secondary end point consolidation randomization: Cumulative Hospitalized Days, Secondary end point consolidation randomization: •OS •CIR, Secondary end point secondary objective: Entire study population: to establish a prospective data registry of relapsed and refractory pediatric AML patients to identify risk factors and improve therapeutic strategies for this population.

Source: https://euclinicaltrials.eu/ctis-public/view/2023-504999-25-00